EU clinical trial 2022-501322-38-00: The NeoTRACK Trial – Neoadjuvant TiRagolumab, Atezolizumab and Chemotherapy – Dissection of IO efficacy in NSCLC by longitudinal tracKing: a non-randomized, open-label, single-arm phase II study
Protocol code: NeoTRACK
Sponsor: Institut fuer Klinische Krebsforschung IKF GmbH (Pharmaceutical company). Phase: Therapeutic exploratory (Phase II). Countries: Germany (temporarily halted).
Therapeutic area(s): Diseases [C] - Respiratory Tract Diseases [C08]
Gender: Female, Male. Age: 18-64 years, 65+ years. Enrolment: 46.
Status: Temporarily halted. Start date (EU): 2023-05-26. Decision date: 2023-03-30. Results received: No. Last updated: 2025-10-29.

Condition(s): Non-small cell lung cancer (NSCLC)
Product: Tiragolumab, ATEZOLIZUMAB

Primary endpoint: • Major pathological response (MPR) rate after curative intent surgery

Source: https://euclinicaltrials.eu/ctis-public/view/2022-501322-38-00